EU clinical trial 2023-508805-26-00: A Clinical Trial to Assess a New Anti-Cancer Treatment (called DSB2455) Given On Its Own in Patients with Advanced Malignancies
Protocol code: DSB2455-001
Sponsor: Duke Street Bio Limited (Pharmaceutical company). Phase: Human Pharmacology (Phase I)- First administration to humans. Countries: Spain (ongoing, recruiting), France (ongoing, recruiting), Hungary (ongoing, recruiting), Poland (authorised, recruiting).
Therapeutic area(s): Not possible to specify
Gender: Female, Male. Age: 18-64 years, 65+ years. Enrolment: 101.
Start date (EU): 2024-10-23. Decision date: 2024-09-23. Results received: No. Last updated: 2026-07-07.
Decision dates by country: FR: 2025-06-04, PL: 2026-03-07, HU: 2026-02-05, ES: 2024-09-23

Condition(s): patients with active brain metastases, where the primary tumour has confirmed BRCA1/2 and/or HRR alterations, ovarian cancer without active brain metastases, mCRPC without active brain metastases, breast cancer without active brain metastases

Source: https://euclinicaltrials.eu/ctis-public/view/2023-508805-26-00